EU clinical trial 2022-502208-64-00: A 52-week, randomised, double blind, multicentre, 2-arm parallel group trial assessing the efficacy and safety of CHF6001 (total daily dose 3200 μg) Dry Powder Inhaler (DPI) add-on to maintenance medium or high dose inhaled corticosteroid in combination with long-acting ß2-agonists in subjects with uncontrolled asthma
Protocol code: CLI-06001AA2-01
Sponsor: Chiesi Farmaceutici S.p.A. (Pharmaceutical company). Phase: Therapeutic exploratory (Phase II). Countries: Italy (ended), Spain (ended), Czechia (ended), Poland (ended), Germany (ended), Latvia (ended), Hungary (ended), Bulgaria (ended), Lithuania (ended), Romania (ended).
Therapeutic area(s): Diseases [C] - Respiratory Tract Diseases [C08]
Gender: Female, Male. Age: 18-64 years, 65+ years. Enrolment: 377.
Status: Ended. Start date (EU): 2023-11-25. End date (EU): 2025-12-09. End date: 2025-12-10. Decision date: 2023-11-06. Results received: No. Last updated: 2025-09-29.
Decision dates by country: PL: 2023-11-09, HU: 2023-11-10, CZ: 2023-11-06, LT: 2023-11-08, LV: 2023-11-10, IT: 2023-11-07, RO: 2024-03-11, BG: 2023-11-13, DE: 2023-11-13, ES: 2023-11-07

Condition(s): Asthma
Product: CHF6001 matching placebo, CHF6001 DPI

Primary endpoint: Number of asthma exacerbations over the 52-week study period.
Endpoint(s): Time to first asthma exacerbation, Number of asthma exacerbation and asthma worsening over 52 weeks of treatment;, Time to first asthma exacerbation or asthma worsening, ACQ-7 responders at Week 4, Week 26 and Week 52 (i.e., subjects showing improvement from baseline in ACQ-7 score of ≥0.5 units), Change from baseline in ACQ-7 and ACQ-6 (i.e. average of the first 6 items of the ACQ-7 questionnaire) score at Week 4, Week 26 and Week 52, Change from baseline in Mini-AQLQ at Week 4, Week 26 and Week 52, Change from baseline in pre-dose FEV1 at Week 4, Week 26 and Week 52, Change from baseline in pre-dose FVC at Week4, Week 52 and Week 26, Change from baseline (run-in period) to each inter-visit period and to the entire treatment period in pre dose morning/evening PEF, Change from baseline to each inter-visit period and to the entire treatment period in the average rescue medication use (number of puffs/day) and asthma symptoms score, Change from baseline to each inter-visit period and to the entire treatment period in the percentage of rescue medication-free days, asthma symptoms-free days and asthma control days

Source: https://euclinicaltrials.eu/ctis-public/view/2022-502208-64-00